EU clinical trial 2025-524431-39-00: An open label, pharmacokinetic and safety study of Combogesic® IV in pediatric patients with acute pain.
Protocol code: AFT-MXIV-08p
Sponsor: Aft Pharmaceuticals Limited (Pharmaceutical company). Phase: Therapeutic confirmatory (Phase III). Countries: Hungary (authorised, recruitment pending).
Therapeutic area(s): Analytical, Diagnostic and Therapeutic Techniques and Equipment [E] - Anesthesia and Analgesia [E03]
Gender: Female, Male. Age: 0-17 years. Enrolment: 40.
Status: Authorised, recruitment pending. Decision date: 2026-03-12. Results received: No. Last updated: 2026-07-14.

Condition(s): Acute pain
Product: Paracetamol/Ibuprofen Vale 1000 mg/300 mg oldatos infúzió

Primary endpoint: The incidence of treatment-emergent adverse events associated with exposure to Combogesic® IV.
Endpoint(s): The time course of treatment-emergent adverse events, The incidence of treatment-related adverse events, The incidence of treatment-emergent adverse events of interest (cardiovascular, gastrointestinal, renal, hepatic, administration site conditions and bleeding-related events), Changes in vital sign measurements, Changes in clinical laboratory values, Patient’s global evaluation of the study drug, Define the pharmacokinetic parameters of Combogesic® IV including: Cmax, Tmax, t½, AUC(0-t), Extrapolated AUC(0-∞), Consumption of supplemental opioid medication in each 24-hour period as Morphine Milligram Equivalent (MME).

Source: https://euclinicaltrials.eu/ctis-public/view/2025-524431-39-00